EU clinical trial 2024-513288-14-00: Prospective, open-label, multicenter, initially 1-arm and, in the event of treatment failure, 3-arm randomised phase III/IV clinical trial on escalating treatment of scabies with INFECTOSCAB 5% (permethrin) (stage I) - with consecutive investigation of the efficacy and safety of two escalated treatment regimens for the treatment of scabies with a higher-concentration permethrin cream (stage II).
Protocol code: ETSKABI
Sponsor: INFECTOPHARM Arzneimittel und Consilium GmbH (Pharmaceutical company). Phase: Therapeutic confirmatory (Phase III). Countries: Germany (ongoing, recruiting).
Therapeutic area(s): Diseases [C] - Parasitic Diseases [C03]
Gender: Female, Male. Age: 0-17 years, 18-64 years, 65+ years. Enrolment: 263.
Status: Ongoing, recruiting. Start date (EU): 2024-10-01. Decision date: 2024-10-24. Results received: No. Last updated: 2026-07-09.

Condition(s): Scabies
Product: DRIPONIN 3 mg Tabletten, Permethrin, InfectoScab® 5 % Crème

Primary endpoint: stage II: Efficacy (yes/no) of treatment with permethrin 10% cream after one or - if necessary - two whole-body applications in study arm A or two whole-body applications in study arm B, assessed 14 days after (last) application, i.e. treatment success on day 14 or day 28 for patients in arm A or on day 21 for patients in arm B., stage I: Efficacy (yes/no) after completion of the first treatment cycle (InfectoScab 5% cream standard therapy, one or - if necessary - two applications), i.e. treatment success on day 14 (for patients with only one InfectoScab 5% cream standard treatment) or on day 28 (for patients with repeated InfectoScab 5% cream standard treatment)
Endpoint(s): stage II: Effectiveness (therapy success) for VA1 and VB4, stage II: Frequency of a required second treatment, overall and depending on the number of antiscabial pre-treatments, stage II: Itching (Numerical Rating Scale (NRS) from 0-10) and change in itching vs. baseline (scale differences) for all visits, stages I + II: Number and type of affected body regions (wrists/hands, arm pits, armpits, genito armpits, armpits, genitoanal region, groin, knees, feet/ankles/lower thighs, head thighs, head, trunk, other) for all visits, stages I + II: Proportion of patients (in %) with evidence of mites (incl. nymphs and larvae, reflected light microscopy or light microscopy of skin samples) for all visits, stages I + II: Proportion of patients with use of non-trial-conforming antiscabiosa for all visits, stage II: Proportion of patients with new scabies efflorescences for all visits, stage II: Patients with “additionally confirmed” treatment failure (in %): Proportion of patients with new scabies efflorescences at the end of study participation OR with mite detection by microscopic examination of a skin sample at the aforementioned time points OR use of other antiscabiosa not conforming to the study protocol, stages I + II: AEs, SAEs, ADRs, SAEs (total frequency, type, severity, causality, with frequencies, with separate presentation of local reactions), stage I: Effectiveness (therapy success) for VE5, VE101/2 (separately and cumulatively) and VEK as well as for the corresponding follow-up visits FUE5/E10/EK, separately and cumulatively by visit type (regular visit, FU visit), stage I: Cumulative efficacy (treatment success) of pure permethrin treatment (i.e. without combined escalation permethrin + ivermectin) by visit type (regular visit, FU visit), stage I: Patients with reinfestation (in %): Proportion of patients with microscopically confirmed new efflorescences at the end of standard therapy or escalated therapy (respective FU) who were assessed as cured at the immediately preceding control-visit., stage I: Effectiveness (therapy success) for VS1 and VS2, as well as for the corresponding follow-up visits FUS1 and FUS2 (separately and cumulatively), stage I: Frequency of required repeated standard therapy and escalated therapy, stage I: Itching (Numerical Rating Scale (NRS) from 0-10) and change in itching vs baseline (scale differences) for all visits, for standard therapy and escalated therapy and for escalated therapy additionally the change in itching vs start of escalated therapy, stage I: Proportion of patients with use of antiscabiosa not conforming to the study protocol for all visits, for standard therapy and escalated therapy, stage I: Proportion of patients with new scabies efflorescences for all treatment cycles and follow-up visits, stage I: Patients with “additionally confirmed” treatment failure (in %): Proportion of patients with new scabies efflorescences at the end of standard therapy (VS2) or escalated therapy (VE5, VEK, VE102) OR with mite detection by microscopic examination of a skin sample at the aforementioned time points OR use of other antiscabiosa not conforming to the study protocol during the respective therapy cycle, stage I: Proportion of patients (in %) with detection of mites (incl. nymphs and larvae, reflected light microscopy or light microscopy of skin samples) for all visits, for standard therapy and escalated therapy

Source: https://euclinicaltrials.eu/ctis-public/view/2024-513288-14-00